EU clinical trial 2024-514838-20-00: Efficacy of domperidone (a prokinetic agent) on time in range in digestively asymptomatic type I diabetic patients with delayed gastric emptying
Protocol code: 2021/0380/HP
Sponsor: Centre Hospitalier Universitaire Rouen (Hospital/Clinic/Other health care facility). Phase: Therapeutic confirmatory (Phase III). Countries: France (authorised, recruitment pending).
Therapeutic area(s): Diseases [C] - Nutritional and Metabolic Diseases [C18]
Gender: Female, Male. Age: 18-64 years, 65+ years. Enrolment: 270.
Status: Authorised, recruitment pending. Decision date: 2024-09-17. Results received: No. Last updated: 2026-07-22.

Condition(s): Type 1 Diabetic patients
Product: Comprimés placebo à usage thérapeutique 260 mg, DOMPÉRIDONE ARROW 10 mg, comprimé pelliculé

Primary endpoint: The primary endpoint of this study is the difference of percentages of time spent within the TIR glycemic target range (70-180 mg/dL) recorded over 14 days under prokinetic treatment (domperidone) or placebo in T1D patients with gastroparesis and inadequate glycemic control
Endpoint(s): Variation in glycemic control criteria between domperidone and placebo (measurement of differences) o HbA1c assay o Plasma fructosamine assay, o number of hypoglycemic episodes, including severe ones, o percentage of time spent in hypoglycemia (<70mg/dL), o percentage of time spent in hyperglycemia (>180mg/dL), o coefficient of glycemic variability, o GMI o TIR, TBR, TAR, CV for each meal; o Insulin dose o Pre- and post-treatment gastric emptying data Tlag, T1/2, Clinical and paraclinical data in each group of T1D patients with or without delayed gastric emptying such as: -Age,sex,duration of diabetes,... -Total insulin dose,treatment modalities -Complications of diabetes: retinopathy,neuropathy,nephropathy,history of foot ulcers,vascular atheroma;cardiac,PAOD -VX neck,HbA1c,fructosamine,nb of hypoglycemic episodes,TIR,TBR,TAR,CV(overall & for each meal);GMI,GRI,blood glucose at start of emptying, 3-day weekly analysis, GCSI score, Number of AE and SAE, Number of times treatment/placebo taken (calculated from number of capsules returned by patient), Ratio of time spent in target range (70-180 mg/dl) over 14 days per subject (in hours)

Source: https://euclinicaltrials.eu/ctis-public/view/2024-514838-20-00